EU clinical trial 2023-503951-81-00: A Phase 2b, randomized, controlled, open-label study to evaluate the immune response and safety of the RSVPreF3 OA investigational vaccine in adults (≥18 years of age) when administered to lung and renal transplant recipients comparing 1 versus 2 doses and compared to healthy controls (≥50 years of age) receiving 1 dose
Protocol code: 219900
Sponsor: GlaxoSmithKline Biologicals (Pharmaceutical company). Phase: Therapeutic exploratory (Phase II). Countries: Spain (ended), Italy (ended), Germany (ended).
Therapeutic area(s): Diseases [C] - Virus Diseases [C02]; Diseases [C] - Respiratory Tract Diseases [C08]
Gender: Female, Male. Age: 18-64 years, 65+ years. Enrolment: 130.
Status: Ended. Start date (EU): 2023-11-07. End date (EU): 2025-07-02. End date: 2025-07-03. Decision date: 2023-10-02. Results received: Yes. Last updated: 2025-04-08.
Decision dates by country: DE: 2023-10-05, ES: 2023-10-02, IT: 2023-10-04

Condition(s): Respiratory Syncytial Virus Infections
Product: Arexvy powder and suspension for suspension for injection Respiratory Syncytial Virus (RSV) vaccine (recombinant, adjuvanted)

Primary endpoint: "•RSV-A serum neutralizing titers expressed as MGI post-Dose 2 (Visit 4*) over post-Dose 1 (Visit 3*) in renal and lung SOT patients in the 2-dose group. ", •RSV-B serum neutralizing titers expressed as MGI post-Dose 2 (Visit 4*) over post-Dose 1 (Visit 3*) in renal and lung SOT patients in the 2-dose group.
Endpoint(s): "Secondary-Immunogenicity: •RSV-A and RSV-B serum neutralizing titers expressed as: - GMT, at pre-study and all post-study intervention visits in all participants. - Group GMT ratio RSV_HA over RSV_IC at V2-6, & IC_2 over IC_1 V4-6 - MGI at Visit 2 and 3 over Visit 1, in RSV_HA and pooled RSV_IC and at Visit 4-6 in all groups. •CMI response expressed as group GMT of the frequency of RSVPreF3-specific CD4+ and/or CD8+ T cells at pre- and all post-study visits in a subset participants.", "Secondary-Safety •Percentage of participants reporting each solicited administration site and systemic events with onset within 7 days post-study intervention administration. •Percentage of participants reporting unsolicited AEs within 30 days post-study intervention administration (i.e., the day of vaccination and 29 subsequent days). •Percentage of participants reporting any SAEs, any pIMDs and any AESIs after study intervention administration up to study end."

Source: https://euclinicaltrials.eu/ctis-public/view/2023-503951-81-00